EU clinical trial 2022-502239-20-00: Cluster and Registry trials Of the Working group of heart failure in Denmark - Are SPironolactone and Eplerenone Comparable Treatments? (CROWD-ASPECT)
Sponsor: Bispebjerg Hospital (Hospital/Clinic/Other health care facility). Phase: Therapeutic use (Phase IV). Countries: Denmark (ongoing, recruiting).
Therapeutic area(s): Diseases [C] - Cardiovascular Diseases [C14]
Gender: Female, Male. Age: 18-64 years, 65+ years. Enrolment: 7200.
Status: Ongoing, recruiting. Start date (EU): 2023-01-01. Decision date: 2022-12-18. Results received: No. Last updated: 2024-04-22.

Condition(s): Heart failure
Product: Spironolactone "Accord", filmovertrukne tabletter, Eplerenon "Stada", filmovertrukne tabletter, Spironolactone "Accord", filmovertrukne tabletter, Eplerenon "Stada", filmovertrukne tabletter

Primary endpoint: death
Endpoint(s): death or hospitalization for heart failure

Source: https://euclinicaltrials.eu/ctis-public/view/2022-502239-20-00